EU clinical trial 2023-505764-11-00: A Randomized Double-Blind Placebo-Controlled Study to Evaluate Efficacy and Safety of Volixibat in the Treatment of Cholestatic Pruritus in Patients with Primary Sclerosing Cholangitis (VISTAS)
Protocol code: VLX-301
Sponsor: Mirum Pharmaceuticals Inc. (Pharmaceutical company). Phase: Therapeutic exploratory (Phase II). Countries: Germany (ongoing, recruitment ended), Belgium (ongoing, recruitment ended), France (ongoing, recruitment ended), Italy (ongoing, recruitment ended), Spain (ongoing, recruitment ended), Netherlands (ongoing, recruitment ended).
Therapeutic area(s): Diseases [C] - Digestive System Diseases [C06]
Gender: Female, Male. Age: 0-17 years, 18-64 years, 65+ years. Enrolment: 105.
Status: Ongoing, recruitment ended. Start date (EU): 2022-06-10. Decision date: 2023-07-18. Results received: No. Last updated: 2026-07-10.
Decision dates by country: FR: 2024-02-21, BE: 2024-03-19, ES: 2024-03-22, NL: 2024-03-11, DE: 2023-07-18, IT: 2024-03-21

Condition(s): Pruritus associated with Primary Sclerosing Cholangitis (PSC)
Product: volixibat, volixibat, Placebo, capsule, hard, oral use

Primary endpoint: Mean change in the Adult ItchRO comparing baseline with the average of the weekly averaged worst daily itch scores.

Source: https://euclinicaltrials.eu/ctis-public/view/2023-505764-11-00